EU clinical trial 2024-513383-26-00: Open label, single-center, cross-over randomized, relative bioavailability study comparing a new pitolisant hydrochloride tablet formulation at 4 different strengths versus the marketed pitolisant (Wakix®) tablet formulation after single oral administrations in healthy subjects
Protocol code: P24-03
Sponsor: Bioprojet Pharma (Pharmaceutical company). Phase: Human Pharmacology (Phase I)- Other. Countries: Belgium (ended).
Therapeutic area(s): Diseases [C] - Nervous System Diseases [C10]
Gender: Female, Male. Age: 18-64 years. Enrolment: 16.
Status: Ended. Start date (EU): 2024-10-01. End date (EU): 2024-12-13. Decision date: 2024-09-12. Results received: No. Last updated: 2024-09-12.

Condition(s): Narcolepsy, Narcolepsy with cataplexy

Source: https://euclinicaltrials.eu/ctis-public/view/2024-513383-26-00